EU clinical trial 2025-521535-36-00: A Phase 1 study of JNJ-95437446 in participants with advanced-stage solid tumors
Protocol code: 95437446LUC1001
Sponsor: Janssen Cilag International (Pharmaceutical company). Phase: Human Pharmacology (Phase I)- First administration to humans. Countries: Spain (ongoing, recruiting).
Therapeutic area(s): Diseases [C] - Neoplasms [C04]
Gender: Female, Male. Age: 18-64 years, 65+ years. Enrolment: 52.
Status: Ongoing, recruiting. Start date (EU): 2025-11-03. Decision date: 2025-10-15. Results received: No. Last updated: 2026-06-08.

Condition(s): Locally advanced, metastatic NSCLC, CRC, or HNSCC that has recurred or progressed after prior stand of care therapy

Source: https://euclinicaltrials.eu/ctis-public/view/2025-521535-36-00